EU clinical trial 2023-509158-68-00: First in human study in healthy volunteers and participants with Parkinsons disease with and without GBA1 mutations.
Protocol code: VQ101-101
Sponsor: Vanqua Bio Inc. (Pharmaceutical company). Phase: Human Pharmacology (Phase I)- First administration to humans. Countries: Netherlands (ongoing, recruiting).
Therapeutic area(s): Diseases [C] - Nervous System Diseases [C10]
Gender: Female, Male. Age: 18-64 years, 65+ years. Enrolment: 200.
Status: Ongoing, recruiting. Start date (EU): 2024-01-25. Decision date: 2024-01-25. Results received: No. Last updated: 2026-07-10.
Decision dates by country: NL: 2024-05-03

Condition(s): Parkinson’s disease

Source: https://euclinicaltrials.eu/ctis-public/view/2023-509158-68-00